EU clinical trial 2024-512037-32-00: Interest of Intra-nodal injection of gentamicin for the treatment of suppurated cat scratch disease's lymphadenitis: a randomized controlled study. "BIGG" : Bartonellosis and intra-nodal injection of gentamicin
Protocol code: 15 7834 08
Sponsor: Centre Hospitalier Universitaire De Toulouse (Hospital/Clinic/Other health care facility). Phase: Therapeutic confirmatory (Phase III). Countries: France (ended).
Therapeutic area(s): Diseases [C] - Bacterial Infections and Mycoses [C01]
Gender: Female, Male. Age: 18-64 years, 65+ years. Enrolment: 100.
Status: Ended. Start date (EU): 2017-05-31. End date (EU): 2025-08-21. Decision date: 2024-09-12. Results received: No. Last updated: 2024-10-16.

Condition(s): Bartonellosis
Product: CHLORURE DE SODIUM PROAMP 0,9 %, solution injectable, ZITHROMAX 250 mg tablett, filmdragerad, GENTAMICINE PANPHARMA 80 mg, solution injectable

Primary endpoint: Frequency at day 28 of CSD’s adenitis favorable outcome characterized as: Reduction of the volume of the adenitis evaluated by echography of ≥ 80% compared to day 0, Without requirement of supplementary needle aspirations after day 7’s visit, And without requirement of a surgical excision or incision of the adenitis.
Endpoint(s): Percentage of volume reduction of the adenitis, evaluated by ultrasound between day 0 and day 28, Percentage of reduction of the pain related to the adenitis evaluated by analogic visual scale between day 0, day 7, and day 28, Number of patients with persisting cutaneous fistulization of the adenitis at day 7, and day 28, Number of patients requiring supplementary needle pus evacuation between day 14 and day 28, Number of patients requiring surgical excision or incision of the adenitis, Percentage of decrease of serum Protein C reactive level between day 0 and day 7, Genotypic profile of resistance to macrolides and aminoglycosides, Safety of the intra-nodal injection of gentamicin

Source: https://euclinicaltrials.eu/ctis-public/view/2024-512037-32-00